EU clinical trial 2026-525263-41-00: Efficacy and Tolerability of N-AVD compared to BrECADD in patients with advanced Hodgkin Lymphoma (N-BRAVE)
Protocol code: PLRG-HL05
Sponsor: Polska Grupa Badawcza Chloniakow (Pharmaceutical company). Phase: Therapeutic confirmatory (Phase III). Countries: Poland (authorised, recruitment pending).
Therapeutic area(s): Diseases [C] - Neoplasms [C04]
Gender: Female, Male. Age: 18-64 years, 65+ years. Enrolment: 370.
Status: Authorised, recruitment pending. Decision date: 2026-05-29. Results received: No. Last updated: 2026-06-01.

Condition(s): Hodgkin lymphoma
Product: ETOPOSIDE, DACARBAZINE, VINBLASTINE SULFATE, Doxorubicin-Ebewe, 2 mg/ml, koncentrat do sporzadzania roztworu do infuzji, DOXORUBICIN HYDROCHLORIDE, DEXAMETHASONE, BRENTUXIMAB VEDOTIN, DACARBAZINE, NIVOLUMAB, Dexaven, 4 mg/ml, roztwór do wstrzykiwań

Primary endpoint: Complete metabolic response (CMR) rate assessed by PET/CT 6–8 weeks after completion of chemotherapy.
Endpoint(s): Progression-Free Survival (PFS), assessed during the whole study period., Event-Free Survival (EFS), assessed during the whole study period., Quality of life (QoL) assessed using the EORTC QLQ-HL27 questionnaire, evaluated before treatment, after 2 cycles of chemotherapy, at the end of chemotherapy, and at each follow-up visit., Treatment-related morbidity (TRMB), assessed as the frequency of adverse events according to the Common Terminology Criteria for Adverse Events (CTCAE), evaluated after each cycle of chemotherapy., Gonadal recovery assessed by follicle-stimulating hormone (FSH) measurement, evaluated 1 year after completion of chemotherapy., Negative residual disease status assessed by circulating tumor DNA (ctDNA) concentration and thymus and activation-regulated chemokine (TARC) concentration, evaluated after 2 chemotherapy cycles and at the end of chemotherapy (at the time of PET assessment)., Overall survival (OS), assessed during the whole study period.

Source: https://euclinicaltrials.eu/ctis-public/view/2026-525263-41-00